EU clinical trial 2023-506143-42-00: A Randomized, Double-Blind Evaluation of the Pharmacokinetics, Safety, and Antiviral Efficacy of Tenofovir Alafenamide (TAF) in Children and Adolescent Subjects with Chronic Hepatitis B Virus Infection
Protocol code: GS-US-320-1092
Sponsor: Gilead Sciences Inc. (Pharmaceutical company). Phase: Therapeutic exploratory (Phase II). Countries: Romania (temporarily halted).
Therapeutic area(s): Diseases [C] - Virus Diseases [C02]
Gender: Female, Male. Age: 0-17 years. Enrolment: 7.
Status: Temporarily halted. Start date (EU): 2018-05-16. Decision date: 2023-08-24. Results received: No. Last updated: 2026-04-20.

Condition(s): Chronic Hepatitis B
Product: PTM-TAF 25 mg tablets, PTM-TAF 7.5 mg granules, Tenofovir Alafenamide 7.5mg oral granules, Vemlidy 25 mg film-coated tablets.

Primary endpoint: Incidence of Treatment-Emergent Serious Adverse Events (SAEs) at Week 24 [ Time Frame: Week 24 ], Incidence of Treatment-Emergent Adverse Events (AEs) at Week 24 [ Time Frame: Week 24 ], Percentage of participants with plasma HBV DNA < 20 IU/mL at Week 24 [ Time Frame: Week 24 ], PK Parameter: AUCtau of TAF for participants from Cohort 2 Part A [ Time Frame: Predose, 15 minutes, 30 minutes, 1, 1.5, 2, 3, 4, 5, and 8 hours postdose at Week 4 or 8 or 12 ]. AUCtau is defined as concentration of drug over time (the area under the concentration verses time curve over the dosing interval).
Endpoint(s): Percentage of participants experiencing graded laboratory abnormalities [ Time Frame: Weeks 24, 48, 96, and 240 ], Development as measured by Tanner Stage Assessment [ Time Frame: Weeks 24, 48, 96, and 240 ], Percentage change from baseline in bone mineral density (BMD) of whole body (minus head) by dual imaging x-ray absorptiometry (DXA) [ Time Frame: Baseline; Weeks 24, 48, 96, and 240 ], Percentage change from baseline in BMD of lumbar spine by DXA [ Time Frame: Baseline; Weeks 24, 48, 96, and 240 ], Change from baseline in serum creatinine [ Time Frame: Baseline; Weeks 4, 8, 12, 24, 48, 96, and 240 ], Change from baseline in estimated glomerular filtration rate (eGFR) by the Schwartz formula [ Time Frame: Baseline; Weeks 24, 48, 96, and 240 ], Incidence of treatment-emergent SAEs in participants treated with TAF or placebo for 24 weeks followed by open-label TAF at Weeks 48, 96 and 240 [ Time Frame: Weeks 48, 96, and 240 ], Incidence of treatment-emergentAEs in participants treated with TAF or placebo for 24 weeks followed by open-label TAF at Weeks 48, 96 and 240 [ Time Frame: Weeks 48, 96, and 240 ], Change from baseline in retinol-binding protein to creatine ratio at Weeks 4, 8, 12, 24, and 48 [ Time Frame: Baseline; Weeks 4, 8, 12, 24, and 48 ], Change from baseline in beta-2-microglobulin to creatine ratio at Weeks 4, 8, 12, 24, and 48 [ Time Frame: Baseline; Weeks 4, 8, 12, 24, and 48 ], Change from baseline in glucose at Weeks 4, 8, 12, 24, and 48 [ Time Frame: Baseline; Weeks 4, 8, 12, 24, and 48 ], Change from baseline in phosphate at Weeks 4, 8, 12, 24, and 48 [ Time Frame: Baseline; Weeks 4, 8, 12, 24, and 48 ], Percentage of participants with plasma HBV DNA < 20 IU/mL at Weeks 48, 96, and 240 [ Time Frame: Weeks 48, 96, and 240 ], Proportion of participants with plasma HBV DNA < 20 IU/mL (target not detected) at Weeks 24, 48, 96, and 240 [ Time Frame: Weeks 24, 48, 96, and 240 ], Percentage of participants with alanine aminotransferase (ALT) normalization at Weeks 24, 48, 96, and 240 [ Time Frame: Weeks 24, 48, 96, and 240 ], Composite endpoint of percentage of participants with ALT normalization and HBV DNA < 20 IU/mL at Weeks 24, 48, 96 and 240 [ Time Frame: Weeks 24, 48, 96 and 240 ], Change from baseline in fibrosis as assessed by FibroTest at Weeks 24, 48, 96, and 240 [ Time Frame: Baseline; Weeks 24, 48, 96, and 240 ], Percentage of participants with hepatitis B e antigen (HBeAg) loss and seroconversion to anti-HBe (HBeAG-positive participants only) at Weeks 24, 48, 96, and 240 [ Time Frame: Weeks 24, 48, 96, and 240 ], Percentage of participants with composite endpoint of HBeAg seroconversion and HBV DNA < 20 IU/mL at Weeks 24, 48, 96, and 240 (in HBeAg-positive participants only) [ Time Frame: Weeks 24, 48, 96, and 240 ], Percentage of participants with composite endpoint of ALT normalization, HBeAg seroconversion and HBV DNA < 20 IU/mL at Weeks 24, 48, 96, and 240 (in HBeAg-positive participants only) [ Time Frame: Weeks 24, 48, 96, and 240 ], Percentage of participants with hepatitis B surface antigen (HBsAg) loss and seroconversion to anti-HBs at Weeks 24, 48, 96, and 240 [ Time Frame: Weeks 24, 48, 96, and 240 ], Percentage of participants with qHBsAg log10 IU/mL at Weeks 24, 48, 96, and 240 [ Time Frame: Weeks 24, 48, 96, and 240 ], Incidence of resistance mutations at Weeks 24, 48, 96, and 240 [ Time Frame: Weeks 24, 48, 96, and 240 ], Acceptability of study drug [ Time Frame: Baseline; Weeks 4, 24, and 36 ] To assess acceptability of study drug, the investigator will ask participants if they were able to taste the medication on a scale of 1-5, how much they like the taste of the medication (1 = dislike very much to 5 = like very much)., Palatability of study drug [ Time Frame: Baseline; Weeks 4, 24, and 36 ] To assess palatability of study drug, the investigator will ask participants on a scale of 0-3 how easy it was to swallow the pill (0 = poor to 3 = excellent)., PK Parameter: AUCtau of tenofovir (TFV) [ Time Frame: Predose, 15 minutes, 30 minutes, 1, 1.5, 2, 3, 4, 5, and 8 hours postdose at Week 4 or 8 (Cohort 1), and Week 4, 8, or 12 (Cohort 2) ] AUCtau is defined as concentration of drug over time (the area under the concentration verses time curve over the dosing interval)., PK Parameter: AUClast of TAF and TFV [ Time Frame: Predose, 15 minutes, 30 minutes, 1, 1.5, 2, 3, 4, 5, and 8 hours postdose at Week 4 or 8 (Cohort 1), and Week 4, 8, or 12 (Cohort 2) ] AUClast is defined as the concentration of drug from time zero to the last observable concentration., PK Parameter: Ctau of TFV [ Time Frame: Predose, 15 minutes, 30 minutes, 1, 1.5, 2, 3, 4, 5, and 8 hours postdose at Week 4 or 8 (Cohort 1), and Week 4, 8, or 12 (Cohort 2) ] Ctau is defined as the observed drug concentration at the end of the dosing interval., PK Parameter: Cmax of TAF and TFV [ Time Frame: Predose, 15 minutes, 30 minutes, 1, 1.5, 2, 3, 4, 5, and 8 hours postdose at Week 4 or 8 (Cohort 1), and Week 4, 8, or 12 (Cohort 2) ] Cmax is defined as the maximum observed concentration of drug., .PK Parameter: Clast of TAF and TFV [ Time Frame: Predose, 15 minutes, 30 minutes, 1, 1.5, 2, 3, 4, 5, and 8 hours postdose at Week 4 or 8 (Cohort 1), and Week 4, 8, or 12 (Cohort 2) ] AUClast is defined as the last observable concentration of drug., PK Parameter: Tmax of TAF and TFV [ Time Frame: Predose, 15 minutes, 30 minutes, 1, 1.5, 2, 3, 4, 5, and 8 hours postdose at Week 4 or 8 (Cohort 1), and Week 4, 8, or 12 (Cohort 2) ] Tmax is defined as the time of Cmax (the maximum concentration of drug)., PK Parameter: Tlast of TAF and TFV [ Time Frame: Predose, 15 minutes, 30 minutes, 1, 1.5, 2, 3, 4, 5, and 8 hours postdose at Week 4 or 8 (Cohort 1), and Week 4, 8, or 12 (Cohort 2) ] Tlast is defined as the time (observed time point) of Clast., PK Parameter: λz of TAF and TFV [ Time Frame: Predose, 15 minutes, 30 minutes, 1, 1.5, 2, 3, 4, 5, and 8 hours postdose at Week 4 or 8 (Cohort 1), and Week 4, 8, or 12 (Cohort 2) ] λz is defined as the terminal elimination rate constant, estimated by linear regression of the terminal elimination phase of the log plasma concentration of drug versus time curve of the drug., PK Parameter: CL/F of TAF and TFV [ Time Frame: Predose, 15 minutes, 30 minutes, 1, 1.5, 2, 3, 4, 5, and 8 hours postdose at Week 4 or 8 (Cohort 1), and Week 4, 8, or 12 (Cohort 2) ] CL/F is defined as the apparent oral clearance following administration of the drug., PK Parameter: Vz/F of TAF and TFV [ Time Frame: Predose, 15 minutes, 30 minutes, 1, 1.5, 2, 3, 4, 5, and 8 hours postdose at Week 4 or 8 (Cohort 1),and Week 4, 8, or 12 (Cohort 2) ] Vz/F is defined as the apparent volume of distribution of the drug, PK Parameter: t1/2 of TAF and TFV [ Time Frame: Predose, 15 minutes, 30 minutes, 1, 1.5, 2, 3, 4, 5, and 8 hours postdose at Week 4 or 8 (Cohort 1), and Week 4, 8, or 12 (Cohort 2) ] t1/2 is defined as the estimate of the terminal elimination half-life of the drug.

Source: https://euclinicaltrials.eu/ctis-public/view/2023-506143-42-00